EU clinical trial 2025-523659-73-00: J3R-MC-YDAL - A Phase 3 Randomized, Double-Blind, Placebo-Controlled Study to Investigate the Efficacy and Safety of Once Weekly Eloralintide in Adult Participants With Persistent Obesity or Overweight Treated With a Weekly Incretin, With and Without Type 2 Diabetes
Protocol code: J3R-MC-YDAL
Sponsor: Eli Lilly & Co. (Pharmaceutical company). Phase: Therapeutic confirmatory (Phase III). Countries: Spain (ongoing, recruiting), Romania (ongoing, recruiting), Belgium (ongoing, recruiting), Czechia (ongoing, recruiting).
Therapeutic area(s): Diseases [C] - Nutritional and Metabolic Diseases [C18]
Gender: Female, Male. Age: 18-64 years, 65+ years. Enrolment: 286.
Status: Ongoing, recruiting. Start date (EU): 2026-05-11. Decision date: 2026-04-21. Results received: No. Last updated: 2026-06-18.
Decision dates by country: ES: 2026-05-08, CZ: 2026-04-21, BE: 2026-04-23, RO: 2026-04-27

Condition(s): Obesity, Overweight
Product: Placebo to match LY, Eloralintide, Eloralintide, Eloralintide, Eloralintide

Primary endpoint: Percent Change from Baseline in Body Weight [Time Frame: Baseline, Week 64]

Source: https://euclinicaltrials.eu/ctis-public/view/2025-523659-73-00